EU clinical trial 2022-502456-31-00: A Phase 1, Open-Label, Multicenter Study of INCA033890 in Participants with Advanced or Metastatic Solid Tumors
Sponsor: Incyte Corp. (Pharmaceutical company). Phase: Human Pharmacology (Phase I)- First administration to humans. Countries: Spain (ongoing, recruiting), Denmark (ongoing, recruiting), Italy (ongoing, recruiting), France (ongoing, recruiting).
Therapeutic area(s): Diseases [C] - Neoplasms [C04]
Gender: Female, Male. Age: 18-64 years, 65+ years. Enrolment: 75.
Status: Ongoing, recruiting. Start date (EU): 2023-11-30. Decision date: 2023-11-07. Results received: No. Last updated: 2026-02-10.
Decision dates by country: IT: 2023-11-07, DK: 2023-11-07, FR: 2023-11-13, ES: 2023-11-08

Condition(s): Advanced or metastatic solid tumors

Source: https://euclinicaltrials.eu/ctis-public/view/2022-502456-31-00